EU clinical trial 2022-503061-29-00: A phase 1/2, first-in-human study on ODM-212 in subjects with selected advanced solid tumours
Protocol code: 3134001
Sponsor: Orion Corporation (Pharmaceutical company). Phase: Phase I and Phase II (Integrated)- First administration to humans. Countries: Spain (ongoing, recruiting), Finland (ongoing, recruiting), France (ongoing, recruiting).
Therapeutic area(s): Diseases [C] - Neoplasms [C04]
Gender: Female, Male. Age: 18-64 years, 65+ years. Enrolment: 174.
Status: Ongoing, recruiting. Start date (EU): 2024-01-22. Decision date: 2023-11-08. Results received: No. Last updated: 2026-07-17.
Decision dates by country: ES: 2023-11-08, FR: 2023-11-13, FI: 2023-11-08

Condition(s): Neoplasms benign malignant and unspecified (incl cysts and polyps). MedDRA [C04]
Product: ODM-212 5 mg coated tablet, ODM-212 40 mg tablet, ODM-212 160 mg coated tablet , ODM-212 40 mg coated tablet , ODM-212 5 mg tablet, ODM-212 80 mg coated tablet

Primary endpoint: Part 1 of the CT: Incidence, frequency and severity of TEAEs; other general safety assessments (laboratory tests, physical examination findings, body temperature, systolic and diastolic BP, 12-lead ECGs incl. HR)., Part 2A: Dose selection based on safety, exposure, and all other available nonclinical, clinical, PK and biomarker data, Part 2B: Antitumour activity is assessed based on: • ORR i.e. the rate of CR and/or PR by BICR according to RECIST v. 1.1 (modified RECIST for MPM). • CBR at week 8, as best response of either CR, PR, or SD at week 8. • CBR, as best response of either CR, PR, or at least 8 weeks of SD.
Endpoint(s): Part 1 of the CT: MTD is defined according to BOIN as the dose for which the estimated toxicity rate (the rate of DLTs) is closest to the target toxicity rate of 25%. A DLT is defined as an event related to ODM- 212 as judged by the investigator and/or the SMB, occurring during the DLT period., Part 1 of the CT: Dose selection based on MTD, DLT, TEAEs, clinical and laboratory assessments., Part 1 of the CT: ODM-212 concentrations and PK variables (Day 1: AUCt, AUC0-12, AUC0-24, AUC∞, λz, Vz/F, Cl/F, t1/2, Cmax, Tmax; Day 15: AUCt, AUC0-12, AUC∞, λz, t1/2, Cmax, Cav, Tmax, Rac,obs)., Part 1 of the CT: Antitumour activity is assessed based on: CBR at week 8, as best response of either CR, PR, or SD at week 8. CBR, as best response of either CR, PR, or at least 8 weeks of SD. ORR as response of either CR or PR. Both defined CBRs and ORR will be assessed according to RECIST v. 1.1 (modified RECIST for MPM, as assessed by the investigator). In addition, antitumour activity is assessed based on change from baseline in ECOG performance status., Part 1 and 2 of the CT: OS will be assessed throughout the study and a survival sweep will be performed 1 year after LSLV., Part 2A of the CT: ORR i.e. the rate of CR and/or PR by the investigator according to RECIST v. 1.1 (modified RECIST for MPM)., Part 2A of the CT: The CBR defined as: as best response of CR and/or PR and/or SD at week 8; as best response of CR and/or PR and/or at least 8 weeks of SD by RECIST v. 1.1 (modified RECIST for MPM)., Part 2A of the CT: PFS will be assessed by the investigator according to RECIST v. 1.1 (modified RECIST for MPM)., Part 2A of the CT: ECOG performance status, CBR, duration of objective response, clinical disease progression., Part 2A of the CT: Incidence, frequency and severity of TEAEs; other general safety assessments (laboratory tests, physical examination findings, body temperature, systolic and diastolic BP, 12-lead ECGs incl. HR)., Part 2B: Time to response and DoR will be assessed by BICR according to RECIST v. 1.1 (modified RECIST for MPM)., Part 2B: PFS will be assessed by BICR according to RECIST v. 1.1 (modified RECIST for MPM)., Part 2B: ORR i.e. the rate of CR and/or PR by the investigator according to RECIST v. 1.1 (modified RECIST for MPM)., Part 2B: Incidence, frequency and severity of TEAEs; other general safety assessments (laboratory tests, physical examination findings, body temperature, systolic and diastolic BP, 12-lead ECGs incl. HR).

Source: https://euclinicaltrials.eu/ctis-public/view/2022-503061-29-00